EU clinical trial 2025-521481-10-00: Early use of dapagliflozin in patients with acute myocardial infarction and reduced ejection fraction: the randomized ARMYDA-9 Dapagliflozin trial
Sponsor: Azienda Ospedaliero-Universitaria Maggiore Della Carita (Hospital/Clinic/Other health care facility). Phase: Therapeutic use (Phase IV). Countries: Italy (authorised, recruitment pending).
Therapeutic area(s): Diseases [C] - Cardiovascular Diseases [C14]
Gender: Female, Male. Age: 18-64 years, 65+ years. Enrolment: 140.
Status: Authorised, recruitment pending. Decision date: 2025-08-22. Results received: No. Last updated: 2025-08-22.

Condition(s): Acute Myocardial Infarction
Product: Forxiga 10 mg film-coated tablets

Primary endpoint: Primary endpoint will be the infarct size, as assessed by cardiac MRI performed at 3-month follow-up, in the two arms. The adjudication of the primary outcome will be performed by a centralized, completely blinded analysis. Infarct size will be measured as percentage of left ventricular mass. Gadobutrol at the dose of 0.15 mmol/Kg will be used as contrast agent, with late gadolinium enhancement starting at 15 min onward. 5-SD will be utilized as method for quantification of infarct size.
Endpoint(s): Clinical secondary outcomes: Time to occurrence of the composite outcome measure including cardiovascular death, worsening HF during index hospitalization or post-discharge HF requiring repeat hospitalization within 3 months. Occurrence of re-MI, stroke or unplanned coronary revascularization at 3 months. All-cause death at 3 months. Duration of in-hospital stay for the index event. Difference in the change of body weight from randomization to 3-month follow-up. Arterial pressure values during h, Imaging secondary outcomes: Cardiac MRI, Transthoracic echocardiography, Laboratory secondary outcomes: B-type natriuretic peptide, Renal function, EPO, Red blood cell

Source: https://euclinicaltrials.eu/ctis-public/view/2025-521481-10-00